EU clinical trial 2024-511805-42-00: Randomized Embedded Multifactorial Adaptive Platform in ExtraCorporeal Membrane Oxygenation (REMAP ECMO) - Beta receptor modulation trial
Protocol code: EUCT 2024-511805-42
Sponsor: Erasmus Universitair Medisch Centrum Rotterdam (Erasmus MC) (Hospital/Clinic/Other health care facility). Phase: Therapeutic exploratory (Phase II). Countries: Netherlands (ongoing, recruiting).
Therapeutic area(s): Diseases [C] - Cardiovascular Diseases [C14]
Gender: Female, Male. Age: 18-64 years, 65+ years. Enrolment: 20.
Status: Ongoing, recruiting. Start date (EU): 2024-05-23. Decision date: 2024-05-10. Results received: No. Last updated: 2025-07-14.

Condition(s): Cardiogenic shock
Product: Esmolol HCl LYO Orpha 2500 mg poeder voor concentraat voor oplossing voor infusie, Milrinon Hikma 1 mg/ml oplossing voor injectie, Dobutamine-hameln 5 mg/ml i.v. infusievloeistof, oplossing voor infusie

Primary endpoint: Change (delta) in heart rate 24 hours after randomization. The average heart rate will be calculated based on all observations during 5 minutes.
Endpoint(s): Percentage of patients having received esmolol and the maximum median dosages after 48 hours., Vasopressor score at baseline, 24 and 48 hours after randomization, using the calculation as described in literature, excluding inotropic medication, Occurrence of new onset ventricular and/or atrial arrhythmias during the first 48 hours after randomization, Left ventricular outflow tract velocity time integral (LVOT VTI), ejection fraction (EF), tricuspid annular plane systolic excursion (TAPSE) at baseline, 24 and 48 hours after randomization, Cardiac output, pulmonary capillary wedge pressure, central venous pressure (measured by pulmonary artery catheter), SVO2 at baseline, 24 and 48 hours after randomization, Lactate level at baseline, 24 and 48 hours after randomization, Troponin at 24 and 48 hours after randomization and Area Under the Curve (AUC), Myocardial oxygen consumption estimated by calculating the pressure volume (PV) area on basis of non-invasive PV loop assessments using echocardiography and pulmonary artery catheter measurements at 24 and 48 hours after randomization, Biomarkers on cardiac stretch and cardiac injury at baseline and 48 hours after randomization, FiO2 suppletion and PEEP level at 24 and 48 hours after randomization, Plasma metanephrines and normetanephrine levels at baseline and 24 hours after randomization

Source: https://euclinicaltrials.eu/ctis-public/view/2024-511805-42-00